EU clinical trial 2025-522618-22-00: A phase III, multicentre, double-blind, randomised, placebo-controlled and open-label study to evaluate the efficacy and safety of a single dose of IPN10200 in the improvement of moderate to severe glabellar lines in adult participants, and to evaluate the long-term efficacy and safety of repeat doses of IPN10200 in the same indication.
Protocol code: CLIN-10200-458
Sponsor: Ipsen Innovation (Pharmaceutical company). Phase: Therapeutic confirmatory (Phase III). Countries: France (ended), Germany (ongoing, recruiting).
Therapeutic area(s): Phenomena and Processes [G] - Physical Phenomena [G01]
Gender: Female, Male. Age: 18-64 years, 65+ years. Enrolment: 230.
Start date (EU): 2026-06-05. Decision date: 2026-05-07. Results received: No. Last updated: 2026-07-31.
Decision dates by country: FR: 2026-05-07, DE: 2026-05-13

Condition(s): Treatment of moderate to severe glabellar lines
Product: Excipients without active substance - Lyophilised powder for solution for injection - Intramuscolar Use

Primary endpoint: 1) For North America: Multi-component response as measured by an improvement of at least 2 grades from baseline and a score of ‘None’ or ‘Mild’ at Week 4 on the Investigator's Live Assessment (ILA) and Subject's self-Assessment (SSA) at Maximum Frown (MF)., 2) For EU and ROW: An improvement of at least 2 grades from baseline at Week 4 on the ILA at MF.
Endpoint(s): 1) DOUBLE BLIND PHASE: Response to treatment as measured by a score of ‘None’ or ‘Mild’ on the Investigator Live Assessment (ILA) at Maximum Frown (MF) at each post treatment visit (except at Week 4 (for EU and ROW) and Week 24)., 2) DOUBLE BLIND PHASE: Response to treatment as measured by a score of ‘None’ or ‘Mild’ on the Subject's Self Assessment (SSA) at MF at each post treatment visit (except Week 24)., 3) DOUBLE BLIND PHASE: Multi-component response as measured by a 2 grade improvement and a score of ‘None’ or ‘Mild’ on both the ILA and SSA at MF at each post treatment visit (except at Week 4 and Week 24 (for North America))., 4) DOUBLE BLIND PHASE: 2-grade improvement on the ILA at MF at each post-treatment visit (except at Week 4 for EU and ROW)., 5) DOUBLE BLIND PHASE: 2-grade improvement on the SSA at MF at each post-treatment visit., 6) DOUBLE BLIND PHASE: 1-grade improvement on the ILA at MF at each post-treatment visit., 7) DOUBLE BLIND PHASE: 1-grade improvement on the SSA at MF at each post-treatment visit., 8) DOUBLE BLIND PHASE: 1-grade improvement on the ILA at rest at each post-treatment visit., 9) DOUBLE BLIND PHASE: ‘Very Satisfied’ or ‘Satisfied’ answer on the SLS at each post treatment visit (except at Week 4 and Week 24 for all regions except United States), 10) DOUBLE BLIND PHASE: Change from baseline in the ageing appearance VAS score of the FACE-Q scale at each post treatment visit., 11) DOUBLE BLIND PHASE: Response as measured by an improvement of at least 10 points from baseline on the Rasch Transformed Score of the FACE-Q Psychological Function Scale at all timepoints (except at Week 4 for EU)., 12) DOUBLE BLIND PHASE: Time to onset of treatment response based on participant’s diary (timeframe Days 1 to 8)., 13) DOUBLE BLIND PHASE: The time taken for a responder to re-exhibit a severity grade of ‘Moderate’ or ‘Severe’ as measured by the ILA at MF following IMP administration. Note: Responder is defined as having a score of ‘None’ or ‘Mild’ on the ILA, 14) DOUBLE BLIND PHASE: Incidence, severity and nature of TEAEs, SAEs or AEs (or SAEs) leading to discontinuations and AESIs (throughout the study duration in the DB Phase)., 15) DOUBLE BLIND PHASE: Clinically significant changes in vital signs, ECGs, facial and focused neurological/physical examination compared to baseline (throughout the study duration in the DB Phase)., 16) DOUBLE BLIND PHASE: Presence of IPN10200 antibodies and titres (binding and neutralising) at screening, end of W4, W12, W24, W36* and W52 (end of the DB Phase). *At Week 36 only if not eligible for retreatment before., 17) OPEN LABEL PHASE: Multi-component response as measured by a 2-grade improvement and a score of ‘None’ or ‘Mild’ on both the ILA and SSA at MF at each post-treatment visit within each cycle., 18) OPEN LABEL PHASE: Response to treatment as measured by a score of ‘None’ or ‘Mild’ on the ILA at MF at each post-treatment visit within each cycle., 19) OPEN LABEL PHASE: Response to treatment as measured by a score of ‘None’ or ‘Mild’ on the SSA at MF at each post-treatment visit within each cycle., 20) OPEN LABEL PHASE: 2-grade improvement and a score of ‘None’ or ‘Mild’ on the ILA at MF at each post-treatment visit within each cycle., 21) OPEN LABEL PHASE: 2-grade improvement and a score of ‘None’ or ‘Mild’ on the SSA at MF at each post-treatment visit within each cycle., 22) OPEN LABEL PHASE: 1-grade improvement on the ILA at MF at each post-treatment visit., 23) OPEN LABEL PHASE: 1-grade improvement on the SSA at MF at each post-treatment visit., 24) OPEN LABEL PHASE: 1-grade improvement on the ILA at rest at each post-treatment visit., 25) OPEN LABEL PHASE: ‘Very Satisfied’ or ‘Satisfied’ answer on the SLS at each post-treatment visit within each cycle., 26) OPEN LABEL PHASE: Change from baseline in the ageing appearance VAS score of the FACE-Q Scale at each post treatment visit within each cycle., 27) OPEN LABEL PHASE: Response as measured by an improvement of at least 10 points from baseline on the Rasch Transformed Score of the FACE-Q Psychological Function Scale at each post treatment visit within each cycle., 28) OPEN LABEL PHASE: The time between two consecutive injections., 29) OPEN LABEL PHASE: Incidence, severity and nature of the TEAEs, SAEs, AEs (or SAEs) leading to discontinuations and AESIs (throughout the study duration in the OL Phase)., 30) OPEN LABEL PHASE: Clinically significant changes in vital signs, facial and focused neurological/physical examination compared to baseline (throughout the study duration in the OL Phase)., 31) OPEN LABEL PHASE: Presence of IPN10200 antibodies and titres (binding and neutralising) at screening, end of W4, W12, W24, W36*, W52 of each cycle and at EOS. *At Week 36 only if not eligible for retreatment before.

Source: https://euclinicaltrials.eu/ctis-public/view/2025-522618-22-00